EU clinical trial 2023-503931-17-00: PHase 3, Multicenter, RandOmized, Double-masked, PlacEbo-CoNtrolled Study of TInlarebant to EXplore Safety and Efficacy in the Treatment of Geographic Atrophy (the PHOENIX Study)
Protocol code: LBS-008-CT05
Sponsor: Belite Bio Inc. (Pharmaceutical company). Phase: Therapeutic confirmatory (Phase III). Countries: Czechia (ongoing, recruiting), France (ongoing, recruiting).
Therapeutic area(s): Diseases [C] - Eye Diseases [C11]
Gender: Female, Male. Age: 18-64 years, 65+ years. Enrolment: 145.
Status: Ongoing, recruiting. Start date (EU): 2024-03-28. Decision date: 2024-02-01. Results received: No. Last updated: 2026-01-26.
Decision dates by country: CZ: 2024-02-20, FR: 2024-02-20

Condition(s): Geographic Atrophy
Product: Placebo to Match Tinlarebant (LBS-008). Placebo tablets will be prepared similarly with microcrystalline cellulose used in place of the active drug substance. The placebo tablet is identical in size, appearance, and other physical properties to the LBS-008 tablet., LBS-008

Primary endpoint: The primary efficacy endpoint of this study is the annualized rate of change in atrophic lesion size (growth rate slope in mm2/year) using all available timepoint measurements over the 24-month study period. Both untransformed and transformed (square root) analyses of lesion growth will be performed.
Endpoint(s): • Change in BCVA as assessed by ETDRS letter score under standard luminance and low luminance from baseline to Month 24, • Exploratory endpoint: Change in photoreceptor morphology (EZ defect area) from baseline to Month 24 (assessed by SD-OCT at the horizontal meridian passing through the foveal center), • Exploratory endpoint: Change in outer, middle, and central subfield retinal thickness from baseline to Month 24 (assessed by SD OCT), Other secondary endpoints: • Change in morphology/anatomy of the RPE and outer retina atrophy from baseline to Month 24, Other secondary endpoints: • Annualized rate of change in atrophic lesion size (growth rate slope) as determined by CFP from baseline to Month 24. Both untransformed and transformed (square root) analyses of lesion growth will be performed., • Correlation between reduction of plasma RBP4 and change in aggregate atrophic lesion size from baseline to Month 24, • Change in retinal sensitivity as assessed by microperimetry from baseline to Month 24, Safety endpoint: • Adverse events (AEs), as defined by the incidence of treatment emergent AEs (TEAEs), serious AEs, drug-related TEAEs, and drug-related serious Aes, Safety endpoint: • Laboratory parameters (hematology, serum chemistry, urinalysis, retinol chemistries), Safety endpoint: • Vital signs, Safety endpoint: • Electrocardiograms (ECGs), Safety endpoint: • Ophthalmological examinations, Safety endpoint: • Color fundus photography (CFP), Safety endpoint: • Change in patient-reported outcome measures using the NEI VFQ-25 and LLQ from baseline to Month 24, Safety endpoint: • Contrast Sensitivity, Safety endpoint: • Dark Adaptation Test (to be completed at selected sites)

Source: https://euclinicaltrials.eu/ctis-public/view/2023-503931-17-00